EU clinical trial 2023-510075-63-00: A multicentre, double-blind, randomized controlled trial of inhaled amikacin versus placebo in critically ill patients with ventilator-associated tracheobronchitis (AMIVAT)
Protocol code: DR230005
Sponsor: Centre Hospitalier Regional Universitaire De Tours (Hospital/Clinic/Other health care facility). Phase: Therapeutic confirmatory (Phase III). Countries: France (authorised, recruitment pending).
Therapeutic area(s): Diseases [C] - Bacterial Infections and Mycoses [C01]; Diseases [C] - Respiratory Tract Diseases [C08]
Gender: Female, Male. Age: 18-64 years, 65+ years. Enrolment: 250.
Status: Authorised, recruitment pending. Decision date: 2026-01-12. Results received: No. Last updated: 2026-04-30.

Condition(s): Patients with ventilator-associated tracheobronchitis
Product: AMIKACINE VIATRIS 1 g, poudre pour solution injectable en flacon, CHLORURE DE SODIUM 0,9 % COOPER, solution pour perfusion

Primary endpoint: Incidence of transition from VAT to VAP at Day 28
Endpoint(s): Incidence of transition from VAT to VAP at Day 7, Overall incidence of a first VAP episode (all pathogens) at Day 28, Overall incidence of a first VAP episode due to MDRB at Day 28, Time to resolution of clinical signs of VAT, Persistence of the pathogens responsible for VAT on ETA at Day 7, Total duration of MV, Number of ventilator-free days at Day 28, Number of defined daily doses of systemic antibiotics (i.e., intravenous and/or enteral administration) at Day 28, Incidence of ICU-acquired intestinal colonization with MDRB at Day 28, Overall incidence of ICU-acquired infection due to MDRB at Day 28, ICU and hospital LOS, All-cause Day-28 and Day-90 mortality rates, HRQoL in survivors at Day 90, Occurrence of respiratory adverse events related to amikacin nebulization (safety analysis), Incidence of AKI at Day 28 (safety analysis), Pharmacokinetics of inhaled amikacin (pre-planned subsample).

Source: https://euclinicaltrials.eu/ctis-public/view/2023-510075-63-00